EU clinical trial 2024-512670-10-00: An Open-Label, Multicentre Phase 1b/2a Clinical Trial of BI-1607, an Fc-Engineered Monoclonal Antibody to FcγRIIB (CD32b), in Combination with Ipilimumab and Pembrolizumab in Participants with Unresectable or Metastatic Melanoma
Protocol code: 23-BI-1607-02
Sponsor: BioInvent International AB (Pharmaceutical company). Phase: Phase I and Phase II (Integrated)- Other. Countries: Germany (ended), Spain (ended).
Therapeutic area(s): Diseases [C] - Neoplasms [C04]
Gender: Female, Male. Age: 18-64 years, 65+ years. Enrolment: 16.
Status: Ended. Start date (EU): 2025-02-13. End date (EU): 2025-10-06. Decision date: 2025-01-13. Results received: No. Last updated: 2025-05-22.
Decision dates by country: ES: 2025-01-13, DE: 2025-01-14

Condition(s): Unresectable or Metastatic Melanoma
Product: KEYTRUDA 25 mg/mL concentrate for solution for infusion, BI-1607, YERVOY 5 mg/ml concentrate for solution for infusion

Primary endpoint: 1. Phase 1b: Occurrence of dose-limiting toxicities (DLTs)., 2. Phase 2a: Best tumour response, objective response rate (ORR) according to Response Evaluation Criteria in Solid Tumour (RECIST) v.1.1 and immune RECIST (iRECIST), progression-free survival (PFS), time to response, duration of response (DoR) and overall survival (OS), 3. Phase 1 and 2a: Frequency and severity of treatment emergent adverse events (TEAEs) and serious adverse events (SAEs) graded according to the National Cancer Institute Common Terminology Criteria for Adverse Events [NCI CTCAE]., 4. Phase 1 and 2a: Changes of vital signs from baseline, 5. Phase 1 and 2a: Changes of laboratory parameters from baseline, 6. Phase 1 and 2a: Changes in electrocardiogram (ECG) value from baseline., 7. Phase 1 and 2a: Frequency and duration of dose interruptions, dose modifications and trial intervention discontinuations
Endpoint(s): 1. Pharmacokinetics (PK)/pharmacodynamics parameters., 2. Number of participants with AEs and SAEs., 3. Response based on RECIST 1.1 (with the support of iRECIST and per Investigator assessment)., 4. Standard PK parameters for BI-1607., 5. Incidence and titre of antidrug antibodies (ADA) to BI-1607 in blood serum.

Source: https://euclinicaltrials.eu/ctis-public/view/2024-512670-10-00